EU clinical trial 2022-500821-34-00: A Study of MK-0482 as Monotherapy and in Combination With Pembrolizumab (MK-3475) in Participants With Advanced Solid Tumors (MK-0482-001)
Protocol code: MK-0482-001
Sponsor: Merck Sharp & Dohme LLC (Pharmaceutical company). Phase: Human Pharmacology (Phase I)- First administration to humans. Countries: Spain (ended), Italy (ended).
Therapeutic area(s): Diseases [C] - Neoplasms [C04]
Gender: Female, Male. Age: 18-64 years, 65+ years. Enrolment: 38.
Status: Ended. Start date (EU): 2021-06-15. End date (EU): 2025-02-17. End date: 2025-06-09. Decision date: 2023-07-21. Results received: No. Last updated: 2025-01-16.
Decision dates by country: ES: 2023-07-21, IT: 2023-07-25

Condition(s): Advanced Solid Tumors

Source: https://euclinicaltrials.eu/ctis-public/view/2022-500821-34-00